EU clinical trial 2022-502076-23-00: Senolytics to Improve Osteoporosis therapy: A randomised controlled clinical trial The SENIOR Trial
Sponsor: Odense University Hospital (Hospital/Clinic/Other health care facility). Phase: Therapeutic exploratory (Phase II). Countries: Denmark (ended).
Therapeutic area(s): Diseases [C] - Hormonal diseases [C19]; Diseases [C] - Nutritional and Metabolic Diseases [C18]
Gender: Female, Male. Age: 18-64 years, 65+ years. Enrolment: 120.
Status: Ended. Start date (EU): 2023-08-16. End date (EU): 2026-04-24. Decision date: 2023-03-01. Results received: No. Last updated: 2026-03-18.

Condition(s): osteopenia, Osteoporosis
Product: DASATINIB

Primary endpoint: Change in circulating marker of bone resorption (CTX) at 21 weeks.
Endpoint(s): Bone resorption marker tartrate resistant acid phosphatase (TRAcP) at 21 weeks., Bone formation markers (PINP, osteocalcin, and bone alkaline phosphatase) at 21 weeks.

Source: https://euclinicaltrials.eu/ctis-public/view/2022-502076-23-00